EU clinical trial 2024-513351-33-00: Telmisartan for portal hypertension in patients with compensated advanced chronic liver disease: A randomized placebo-controlled, double-blind trial
Protocol code: TECA
Sponsor: Medical University Of Vienna (Educational Institution). Phase: Therapeutic exploratory (Phase II). Countries: Austria (ongoing, recruiting).
Therapeutic area(s): Diseases [C] - Digestive System Diseases [C06]
Gender: Female, Male. Age: 18-64 years, 65+ years. Enrolment: 100.
Status: Ongoing, recruiting. Start date (EU): 2025-03-21. Decision date: 2025-01-13. Results received: No. Last updated: 2026-06-29.

Condition(s): compensated advanced chronic liver disease, portal hypertension
Product: Telmicard 40 mg-Tabletten, Placebo consists of gelatin capsules filled with maltodextrin

Primary endpoint: The primary endpoint is defined as the difference between HVPG at W12 and baseline.
Endpoint(s): HVPG response after 12 weeks of treatment is defined as an HVPG decrease ≥10%; i.e., HVPG responders)., Change in liver stiffness measurement (in kPa) between W12 and baseline, Change in spleen stiffness measurement (in kPa) between W12 and baseline)

Source: https://euclinicaltrials.eu/ctis-public/view/2024-513351-33-00